EU clinical trial 2024-514809-67-00: A Phase 1/2a Study Evaluating the Effects of ARO-MUC5AC Inhalation Solution in Healthy Subjects and Patients with Muco-Obstructive Lung Disease
Protocol code: AROMUC5AC-1001
Sponsor: Arrowhead Pharmaceuticals Inc. (Pharmaceutical company). Phase: Phase I and Phase II (Integrated)- Other. Countries: Poland (ended), Spain (ended).
Therapeutic area(s): Diseases [C] - Respiratory Tract Diseases [C08]
Gender: Female, Male. Age: 18-64 years, 65+ years. Enrolment: 32.
Status: Ended. Start date (EU): 2023-06-21. End date (EU): 2024-10-24. End date: 2024-11-12. Decision date: 2024-07-24. Results received: Yes. Last updated: 2024-10-01.
Decision dates by country: ES: 2024-07-24, PL: 2024-08-04

Condition(s): Asthma and Chronic obstructive pulmonary disease
Product: 0.9% sodium chloride - inhalation solution, ARO-MUC5AC Inhalation Solution

Primary endpoint: The incidence and frequency of treatment-emergent adverse events (TEAEs) over time through end of study (EOS)
Endpoint(s): 1. Change from baseline over time through EOS in forced expiratory volume (FEV1) as a safety assessment, 2. Change from baseline over time through EOS in forced vital capacity (FVC) as a safety assessment, 3. Plasma PK parameters of ARO-MUC5AC

Source: https://euclinicaltrials.eu/ctis-public/view/2024-514809-67-00